EU clinical trial 2024-512785-33-00: A Phase 2/3, Randomized, Double-Blinded, Placebo-Controlled, Parallel-Group, 2-Arm, Multicenter, Operationally Seamless Study to Evaluate the Efficacy, Safety, Tolerability, Pharmacodynamics, Pharmacokinetics, and Immunogenicity of Efgartigimod PH20 SC in Participants Aged 18 Years and Older With Active Idiopathic Inflammatory Myopathy
Protocol code: ARGX-113-2007
Sponsor: Argenx (Pharmaceutical company). Phase: Phase II and Phase III (Integrated). Countries: Slovakia (ended), Sweden (ended), France (ended), Germany (ended), Czechia (ended), Netherlands (ended), Cyprus (ended), Denmark (ended), Hungary (ended), Ireland (ended), Bulgaria (ended), Belgium (ended), Poland (ended), Lithuania (ended), Portugal (ended), Spain (ended), Austria (ended), Italy (ended), Greece (ended).
Therapeutic area(s): Diseases [C] - Musculoskeletal Diseases [C05]
Gender: Female, Male. Age: 18-64 years, 65+ years. Enrolment: 186.
Status: Ended. Start date (EU): 2023-03-01. End date (EU): 2026-07-02. End date: 2026-07-03. Decision date: 2024-08-14. Results received: No. Last updated: 2026-06-02.
Decision dates by country: AT: 2024-08-20, CY: 2024-08-19, CZ: 2024-08-15, DK: 2024-08-14, LT: 2024-08-14, PT: 2024-08-16, SE: 2024-08-14, NL: 2024-08-19, SK: 2024-08-14, PL: 2024-08-16, HU: 2024-08-14, IE: 2024-08-14, FR: 2024-08-14, BG: 2024-08-15, BE: 2024-08-19, GR: 2024-08-22, IT: 2024-08-20, ES: 2024-08-19, DE: 2024-08-15

Condition(s): Active Idiopathic Inflammatory Myopathy (IIM)
Product: Placebo to ARGX-113 solution for injection, ARGX-113

Primary endpoint: Mean total improvement score (TIS) at week 52
Endpoint(s): 1. Time to reach sustained TIS ≥40 (“moderate clinical improvement”), 2. Percentage of participants with TIS ≥40 at week 52, 3. Percentage of participants with TIS ≥60 at week 52, 4. Change in manual muscle testing-8 (MMT8) score at week 52, 5. Change in Patient Global Assessment of Disease Activity (PGA) at week 52, 6. Change in Physician Global Assessment of Disease Activity (MDGA) at week 52, 7. Proportion of participants who have at least moderate improvement (≥40) in TIS at week 52 and adhere to an oral prednisone dosage of ≤5 mg/day (or equivalent) from week 44 onward, 8. Change in CK abnormality grades at week 52, 9. Change in Cutaneous Dermatomyositis Disease Area and Severity Index (CDASI) activity score at week 52

Source: https://euclinicaltrials.eu/ctis-public/view/2024-512785-33-00